EU clinical trial 2023-503898-38-00: I4V-MC-JAIP: A Phase 3, Multicenter, Randomized, Double blind, Placebo controlled, Parallel group, Outpatient Study Evaluating the Pharmacokinetics, Efficacy, and Safety of Baricitinib in Pediatric Patients with Moderate-to-Severe Atopic Dermatitis
Protocol code: I4V-MC-JAIP
Sponsor: Eli Lilly & Co. (Pharmaceutical company). Phase: Therapeutic confirmatory (Phase III). Countries: Hungary (ended), Czechia (ended), Poland (ended), France (ended), Austria (ended), Spain (ended), Germany (ended).
Therapeutic area(s): Diseases [C] - Skin and Connective Tissue Diseases [C17]
Gender: Female, Male. Age: 0-17 years. Enrolment: 194.
Status: Ended. Start date (EU): 2019-05-24. End date (EU): 2026-03-24. End date: 2026-05-22. Decision date: 2024-04-19. Results received: No. Last updated: 2026-07-16.
Decision dates by country: FR: 2024-04-19, DE: 2024-04-22, HU: 2024-04-19, PL: 2024-04-22, CZ: 2024-04-19, AT: 2024-04-23, ES: 2024-04-23

Condition(s): Atopic Dermatitis
Product: BARICITINIB, BARICITINIB, TRIAMCINOLONE ACETONIDE, HYDROCORTISONE, Placebo to match 4 mg tablet, BARICITINIB, Baricitinib, Placebo to match 1mg tablet, Placebo to match 2mg tablet, HYDROCORTISONE, Hydrocutan Creme 1 %, Placebo to match 2mg/ml oral suspension

Primary endpoint: 1. Percentage of Participants Achieving Investigator's Global Assessment (IGA) of 0 or 1 With a ≥2 Point Improvement, 2. Open Label Population Pharmacokinetics (Pop PK): Maximum Observed Drug Concentration at Steady State (Cmax,ss) of LY3009104., 3. Open Label Pop PK: Area Under the Concentration-Time Curve for Dosing Interval at Steady State (AUCtau,ss) of LY3009104, 4. Open label Pop PK: AUCtau,ss was derived by a population pharmacokinetics approach

Source: https://euclinicaltrials.eu/ctis-public/view/2023-503898-38-00